EU clinical trial 2025-522472-85-00: Toripalimab plus chemotherapy as first-line treatment for recurrent and/or metastatic nasopharyngeal cancer: safety and activity in non-endemic population
Sponsor: Humanitas Mirasole S.p.A. (Hospital/Clinic/Other health care facility). Phase: Therapeutic confirmatory (Phase III). Countries: Italy (ongoing, recruiting).
Therapeutic area(s): Diseases [C] - Neoplasms [C04]
Gender: Female, Male. Age: 18-64 years, 65+ years. Enrolment: 49.
Status: Ongoing, recruiting. Start date (EU): 2026-06-08. Decision date: 2025-10-13. Results received: No. Last updated: 2026-04-28.

Condition(s): Recurrent Metastatic Nasopharingeal Carcinoma
Product: Cisplatino Hikma 1mg/ml concentrato per soluzione per infusione, CISPLATINO SANDOZ, Gemcitabina Hikma 200 mg polvere per soluzione per infusione, Gemcitabina Aurobindo Pharma Italia 40 mg/ml concentrato per soluzione per infusione, Gemcitabina Accord 100 mg/ml concentrato per soluzione per infusione., Solgekma 38mg/ml concentrato per soluzione per infusione, CISPLATINO SANDOZ, Gemcitabina Hikma 2g polvere per soluzione per infusione, CISPLATINO Pfizer 50 mg/50 ml soluzione per infusione, Cisplatino Accord Healthcare Italia 1 mg/ml concentrato per soluzione per infusione, Cisplatino Teva Italia 1 mg/ml concentrato per soluzione per infusione, Gemcitabina SUN 1 g polvere per soluzione per infusione, LOQTORZI 240 mg concentrate for solution for infusion, GEMSOL, Gemcitabina Hikma 1 g polvere per soluzione per infusione

Primary endpoint: Incidence of high-grade (CTCAE v 5.0 grade 3 or higher), treatment related adverse events
Endpoint(s): Incidence of all high-grade (Grades 3-5), selected adverse events, independently from the association with the study drugs;, Median time to onset and median time to resolution (Grades 3-4) of selected adverse events (resolution of an AE is a subject experiencing complete resolution or improvement to the baseline grade for the AE);, Safety and tolerability measured by the incidence of all AEs, treatment-related AEs, serious AEs, deaths, laboratory abnormalities, and select AEs such as pulmonary, gastrointestinal, skin, renal, hepatic, pancreatic, neurologic, endocrine, infusion-related, or hypersensitivity., Investigator-assessed Progression Free Survival (PFS) defined as radiological evidence of progression, significant clinical symptomatic progression, the need to introduce a non-study drug therapy or death from any cause., Overall Survival defined as the time from first dosing date to the date of death. A subject who has not died will be censored at last known date alive.

Source: https://euclinicaltrials.eu/ctis-public/view/2025-522472-85-00